EU clinical trial 2025-521488-11-00: Psilocybin-Assisted Psychotherapy for Posttraumatic Stress Disorder in Military Veterans: A Pilot Feasibility Study
Protocol code: PsiVet
Sponsor: ARQ National Psychotrauma Centrum (Patient organisation/association). Phase: Therapeutic exploratory (Phase II). Countries: Netherlands (authorised, recruitment pending).
Therapeutic area(s): Psychiatry and Psychology [F] - Mental Disorders [F03]
Gender: Female, Male. Age: 18-64 years, 65+ years. Enrolment: 12.
Status: Authorised, recruitment pending. Decision date: 2026-06-22. Results received: No. Last updated: 2026-06-22.

Condition(s): Posttraumatic stress disorder
Product: PEX010 Psilocybin Capsules (25 mg Psilocybin), PEX010 Psilocybin Capsules (5 mg Psilocybin)

Primary endpoint: Number, percentage and reasons of screen failures and drop-out, Descriptive statistics of the scores on the Treatment Acceptability/Adherence Scale (TAAS-M), measured post-treatment (Visit 16), Qualitative analysis of semi-structured interviews conducted with participants post-treatment (Visit 16), Mean change in CAPS-5-R Total Severity Score from Baseline (Visit 4) to 13 weeks post Baseline (Visit 15)., Severity, incidence and frequency of adverse events (AEs), serious adverse events (SAEs), suicidal ideation and behavior, concomitant medication use, and vital signs throughout the study, Descriptive statistics of changes in Columbia Suicide Severity Rating Scale (C-SSRS) scores, Descriptive statistics of concomitant medication use, Mean changes in blood pressure, heart rate, and body temperature from pre-psilocybin administration to end of each Psilocybin Session
Endpoint(s): Mean change in Sheehan Disability Scale Total Severity Score from Baseline (Visit 4) to 13 weeks post Baseline (Visit 15)., Mean change in Beck's Depression Inventory-II Total Severity Score from Baseline (Visit 4) to 13 weeks post Baseline (Visit 15)

Source: https://euclinicaltrials.eu/ctis-public/view/2025-521488-11-00